EU clinical trial 2024-511125-61-00: An open-label, multi-center rollover protocol for patients who have participated in a Novartis-sponsored ribociclib (LEE011) study and are continuing to benefit from ribociclib as single agent or in combination with other investigational treatments
Protocol code: CLEE011X2X01B
Sponsor: Novartis Pharma AG (Pharmaceutical company). Phase: Phase I and Phase II (Integrated)- Other. Countries: Spain (ongoing, recruitment ended), Germany (ongoing, recruitment ended).
Therapeutic area(s): Not possible to specify
Gender: Female, Male. Age: 0-17 years, 18-64 years, 65+ years. Enrolment: 2.
Status: Ongoing, recruitment ended. Start date (EU): 2017-03-08. Decision date: 2024-04-17. Results received: No. Last updated: 2026-06-29.
Decision dates by country: ES: 2024-04-17, DE: 2025-08-27

Condition(s): Different types of advanced cancer
Product: EGF816, EGF816, LEE011, LEE011, Kisqali 200 mg film-coated tablets

Primary endpoint: Number of patients receiving ribociclib as single agent or in combination with other investigational treatments under the rollover study, duration of exposure
Endpoint(s): Frequency and nature of adverse events (AEs), serious adverse events (SAE) and liver function tests

Source: https://euclinicaltrials.eu/ctis-public/view/2024-511125-61-00